EU clinical trial 2025-521910-24-00: Effects of CLADribine tablets on the Immune Synapse, in Relapsing Multiple Sclerosis (RMS) patients_CLADIS.
Protocol code: MS700568_0198
Sponsor: Aristotle University Of Thessaloniki (Educational Institution). Phase: Therapeutic use (Phase IV). Countries: Greece (authorised, recruitment pending).
Therapeutic area(s): Diseases [C] - Nervous System Diseases [C10]
Gender: Female, Male. Age: 18-64 years. Enrolment: 30.
Status: Authorised, recruitment pending. Decision date: 2026-04-17. Results received: No. Last updated: 2026-07-03.

Condition(s): Multiple Sclerosis
Product: MAVENCLAD 10 mg tablets

Primary endpoint: Change in the expression of the co-stimulatory and adhesion molecules comprising the immune synapse in the relevant subpopulations of the adaptive and innate immune system, at 12- months of treatment, relative to baseline
Endpoint(s): Change in the expression of the co-stimulatory and adhesion molecules comprising the immune synapse in the relevant subpopulations of the adaptive and innate immune system, at 6- months of treatment, relative to baseline, Change in the ARR at year 1, relative to the 12-month pre-treatment period, Change in EDSS at the end of year 1, compared to baseline, Change in T25FW at the end of year 1, compared to baseline, Change in 9HPT at the end of year 1, compared to baseline, Number of T1 lesions (Gd+ and black holes) at the end of year 1, compared to baseline, Number of T2 lesions (total, new/enlarging) at the end of year 1, compared to baseline, Number CUA at the end of year 1, compared to baseline, Proportion of patients with NEDA-3 at the end of year 1, Proportion of patients with MEDA-3 at the end of year 1, Correlation of changes in the expression of Immune Synapse molecules in the immune cell populations of interest, with clinical outcomes at the end of year 1, Correlation of changes in the expression of Immune Synapse molecules in the immune cell populations of interest, with MRI outcomes at the end of year 1

Source: https://euclinicaltrials.eu/ctis-public/view/2025-521910-24-00